EU clinical trial 2024-516945-37-00: Phase Ib of Cyclophosphamide, Pomalidomide, Dexamethasone and Daratumumab (CPD-DARA) in patients with relapsed/refractory multiple myeloma. (The CPD-DARA Study).
Protocol code: CTRIAL-IE 19-17
Sponsor: Cancer Trials Ireland (Patient organisation/association). Phase: Human Pharmacology (Phase I)- Bioequivalence Study. Countries: Ireland (ended).
Therapeutic area(s): Diseases [C] - Neoplasms [C04]
Gender: Female, Male. Age: 18-64 years, 65+ years. Enrolment: 16.
Status: Ended. Start date (EU): 2021-11-04. End date (EU): 2025-09-09. Decision date: 2024-10-29. Results received: No. Last updated: 2025-08-18.

Condition(s): Relapsed/ refractory multiple myeloma

Source: https://euclinicaltrials.eu/ctis-public/view/2024-516945-37-00